EU clinical trial 2022-502125-17-00: A study to find a suitable dose of BI 1821736 and test whether it helps people with advanced cancer
Protocol code: 1467-0001
Sponsor: Boehringer Ingelheim International GmbH, Boehringer Ingelheim Espana S.A. (Pharmaceutical company). Phase: Human Pharmacology (Phase I)- First administration to humans. Countries: Sweden (ended), Spain (ended).
Therapeutic area(s): Diseases [C] - Neoplasms [C04]
Gender: Female, Male. Age: 18-64 years, 65+ years. Enrolment: 14.
Status: Ended. Start date (EU): 2023-10-16. End date (EU): 2025-04-10. End date: 2025-04-11. Decision date: 2023-09-08. Results received: No. Last updated: 2025-06-16.
Decision dates by country: SE: 2023-09-11, ES: 2023-09-08

Condition(s): Advanced solid tumors

Source: https://euclinicaltrials.eu/ctis-public/view/2022-502125-17-00